EU clinical trial 2024-519998-19-00: A trial in healthy participants to examine the safety, tolerability, and pharmacokinetics of orally administered FT751
Protocol code: FT751-1001
Sponsor: Forward Therapeutics Inc. (Pharmaceutical company). Phase: Human Pharmacology (Phase I)- First administration to humans. Countries: Germany (ended).
Therapeutic area(s): Diseases [C] - Immune System Diseases [C20]
Gender: Female, Male. Age: 18-64 years, 65+ years. Enrolment: 120.
Status: Ended. Start date (EU): 2025-03-31. End date (EU): 2026-02-24. Decision date: 2025-03-06. Results received: No. Last updated: 2026-02-19.

Condition(s): Inflammatory diseases

Source: https://euclinicaltrials.eu/ctis-public/view/2024-519998-19-00